EU clinical trial 2025-524199-40-00: A PET-MRI study of serotoninergic brainstem pathway in patients with Dravet Syndrome - DRAPETONINE
Protocol code: 69HCL24_1231
Sponsor: Hospices Civils De Lyon (Hospital/Clinic/Other health care facility). Phase: Therapeutic exploratory (Phase II). Countries: France (ongoing, recruiting).
Therapeutic area(s): Diseases [C] - Nervous System Diseases [C10]
Gender: Female, Male. Age: 18-64 years. Enrolment: 30.
Status: Ongoing, recruiting. Start date (EU): 2026-05-04. Decision date: 2026-02-06. Results received: No. Last updated: 2026-02-06.

Condition(s): neurology
Product: [18F]-MPPF

Primary endpoint: Comparison of the brainstem BPND of [18F]-MPPF across patients groups (DS and focal epilepsy)
Endpoint(s): Comparison of the brainstem BPND of [18F]-MPPF of each patients group (DS and focal epilepsy) with the one of healthy subjects, Comparison of the cortical BPND of [18F]-MPPF across patients groups (DS and focal epilepsy) and with the one of healthy subjects, aluating the relation between [18F]-MPPF PET brainstem regional distribution of 5HT1A receptors and inter-ictal respiratory function in patients with DS, Comparing brainstem regional volumes on MRI of patients with DS with the one of patients with drug-resistant focal epilepsy, Comparing brainstem regional volumes on MRI of each patients group (DS and focal epilepsy) with the one of healthy subjects, Evaluating the relation between the brainstem regional volumes on MRI and inter-ictal respiratory function in patients with DS

Source: https://euclinicaltrials.eu/ctis-public/view/2025-524199-40-00